EU clinical trial 2023-503539-16-00: A Randomized, Open-label, Phase 3 Study of MK-2870 vs Chemotherapy (Docetaxel or Pemetrexed) in Previously Treated Advanced or Metastatic Nonsquamous Non-small Cell Lung Cancer (NSCLC) with EGFR Mutations or Other Genomic Alterations
Protocol code: MK2870-004
Sponsor: Merck Sharp & Dohme LLC (Pharmaceutical company). Phase: Therapeutic confirmatory (Phase III). Countries: Greece (ongoing, recruitment ended), Poland (ongoing, recruitment ended), Germany (ongoing, recruitment ended), Czechia (ongoing, recruitment ended), France (ongoing, recruitment ended), Italy (ongoing, recruitment ended), Spain (ongoing, recruitment ended).
Therapeutic area(s): Diseases [C] - Neoplasms [C04]
Gender: Female, Male. Age: 18-64 years, 65+ years. Enrolment: 107.
Status: Ongoing, recruitment ended. Start date (EU): 2025-11-11. Decision date: 2024-02-06. Results received: No. Last updated: 2026-03-12.
Decision dates by country: DE: 2024-02-09, CZ: 2024-02-09, GR: 2024-02-12, FR: 2024-02-12, IT: 2024-02-07, PL: 2024-02-09, ES: 2024-02-06

Condition(s): Non-small Cell Lung Cancer (NSCLC)
Product: DOCETAXEL, DEXAMETHASONE, MK-2870, PARACETAMOL, COMBINATIONS EXCL. PSYCHOLEPTICS, PEMETREXED

Primary endpoint: Progression-free Survival (PFS) of Participants with NSCLC with Epidermal Growth Factor Receptor (EGFR) mutations, Overall Survival (OS) of Participants with NSCLC with EGFR mutations
Endpoint(s): PFS of All Participants with NSCLC, OS of All Participants with NSCLC, Objective Response Rate (ORR) of Participants with NSCLC with EGFR mutations, ORR of All Participants with NSCLC, Duration of Response (DOR) of All Participants with NSCLC, Change in Score from Baseline in Global Health Status/QoL Score (European Organisation for Research and Treatment of Cancer (EORTC) Quality of Life Questionnaire-Core 30 (QLQ-C30) items 29 and 30), Change in Score from Baseline in Dyspnea score (EORTC QLQ-C30 item 8), Change in Score from Baseline in Cough (EORTC Quality of Life Questionnaire-Lung Cancer 13 (QLQ-LC13) item 31), Change in Score from Baseline in Chest pain (EORTC QLQ-LC13 item 40), Time to Deterioration from Baseline in Global Health Status/QoL Score (EORTS QLQ-C30 items 29 and 30), Time to Deterioration from Baseline in Dyspnea score (EORTC QLQ-C30 item 8), Time to Deterioration from Baseline in Cough (EORTC Quality of Life Questionnaire-Lung Cancer 13 (QLQ-LC13) item 31), Time to Deterioration from Baseline in Chest pain (EORTC QLQ-LC13 item 40), Number of Participants Who Experience One or More Adverse Events (AEs), Number of Participants Who Discontinue Study Treatment Due to an Adverse Event (AE)

Source: https://euclinicaltrials.eu/ctis-public/view/2023-503539-16-00